EU clinical trial 2022-500860-36-00: A Phase III, randomized, double-blind, placebo-controlled, multicenter, international study of Osimertinib as maintenance therapy in patients with locally advanced, unresectable EGFR mutation-positive Non-Small Cell Lung Cancer (Stage III) whose disease has not progressed following definitive platinum-based chemoradiation therapy (LAURA).
Protocol code: D5160C00048
Sponsor: Astrazeneca AB (Pharmaceutical company). Phase: Therapeutic confirmatory (Phase III). Countries: Spain (ongoing, recruitment ended).
Therapeutic area(s): Psychiatry and Psychology [F] - Behavior and Behavior Mechanisms [F01]; Phenomena and Processes [G] - Circulatory and Respiratory Physiological Phenomena [G09]; Analytical,Diagnostic,Therapeutic Techniques and Equipment [E]-Surgical Procedures, Operative [E04]; Diseases [C] - Neoplasms [C04]; Diseases [C] - Hemic and Lymphatic Diseases [C15]
Gender: Female, Male. Age: 18-64 years, 65+ years. Enrolment: 10.
Status: Ongoing, recruitment ended. Start date (EU): 2018-09-19. Decision date: 2024-06-07. Results received: No. Last updated: 2026-07-09.

Condition(s): Histologically documented non-small cell lung cancer of predominantly non-squamous pathology who present with locally advanced, unresectable (Stage III) disease, whose tumor tissue has EGFR exon 19 deletions or exon 21 (L858R) substitution mutations, either alone or in combination with other EGFR mutations, as detected by cobas® EGFR Mutation Test v2 (Roche Diagnostics) and whose disease has not progressed following definitive platinum-based chemoradiation.
Product: TAGRISSO 80 mg film-coated tablets, TAGRISSO 40 mg film-coated tablets, PLACEBO

Primary endpoint: PFS using BICR assessment according to RECIST v1.1 Sensitivity analysis of PFS using Investigator assessment according to RECIST v1.1
Endpoint(s): PFS in patients with EGFR Ex19del or L858R mutation and Patients with EGFRm+ Ex19del or L858R detectable in plasma-derived ctDNA using BICR assessment according to RECIST v1.1; Sensitivity analysis of PFS using Investigator assessment according to RECIST v1.1, Time to CNS PFS (time to the earliest of CNS progression or death) using BICR assessments according to RECIST v1.1; Cumulative incidence rate of CNS PFS by BICR at 12 and 24 months, OS, ORR, DoR, DCR and tumor shrinkage, TTDM using BICR assessments according to RECIST v1.1, Time to treatment discontinuation (TTD), Second progression free survival on a subsequent treatment (PFS2), Time to first subsequent therapy (TFST), Time to second subsequent therapy (TSST), Change from baseline in European Organization for Research and Treatment of Cancer Quality of Life Questionnaire – Core 30 items (EORTC QLQ-C30): Change from baseline in European Organization for Research and Treatment of Cancer Quality of Life Questionnaire – Lung Cancer 13 items (EORTC QLQ-LC13), Adverse Events (graded by CTCAE v5); Clinical chemistry, hematology and urinalysis; Vital signs (pulse and blood pressure), physical examination, weight; ECG parameters; Left ventricular ejection fraction; WHO Performance Status, Trough plasma concentrations of osimertinib, and its metabolite AZ5104 If conducted, PK Parameters (CLss/F, Css, min and Css, max, AUCss) may be derived using population PK analysis and reported separately to the CSR. Data from this study may form part of a pooled analysis with data from other studies

Source: https://euclinicaltrials.eu/ctis-public/view/2022-500860-36-00